EU clinical trial 2024-518532-36-00: Urea treatment of hyponatremia in subarachnoid hemorrhage
Protocol code: 38RC19.189
Sponsor: Centre Hospitalier Universitaire Grenoble Alpes (Hospital/Clinic/Other health care facility). Phase: Therapeutic exploratory (Phase II). Countries: France (ended).
Therapeutic area(s): Analytical, Diagnostic and Therapeutic Techniques and Equipment [E] - Anesthesia and Analgesia [E03]
Gender: Female, Male. Age: 18-64 years, 65+ years. Enrolment: 52.
Status: Ended. Start date (EU): 2020-10-15. End date (EU): 2025-03-13. Decision date: 2024-11-29. Results received: No. Last updated: 2024-11-29.

Condition(s): hyponatremia during subarachnoid hemorrhage
Product: ergytonyl placebo, Urea

Primary endpoint: Change in natraemia in mmol/L measured before and on day of treatment discontinuation
Endpoint(s): Compare the sodium intake required to correct natraemia, Study the mechanism of action of urea, Évaluer l’impact du traitement sur la durée de séjour, Évaluer l’impact du traitement sur le devenir neurologique à 3 mois de l’inclusion, Assessing adverse effects of treatment, Persistence of natraemia correction 48H after discontinuation of treatment, Comparison of speed of correction of natraemia

Source: https://euclinicaltrials.eu/ctis-public/view/2024-518532-36-00